EU clinical trial 2024-510769-41-00: SGM-T1: SGM-101 tumor targeted fluorescence endoscopy in rectal polyps with suspected T1 adenocarcinoma or high grade dysplasia
Protocol code: NL83765.058.23
Sponsor: Academisch Ziekenhuis Leiden (Hospital/Clinic/Other health care facility). Phase: Therapeutic exploratory (Phase II). Countries: Netherlands (ended).
Therapeutic area(s): Diseases [C] - Digestive System Diseases [C06]; Diseases [C] - Neoplasms [C04]
Gender: Female, Male. Age: 18-64 years, 65+ years. Enrolment: 20.
Status: Ended. Start date (EU): 2023-12-07. End date (EU): 2025-08-11. Decision date: 2024-10-16. Results received: No. Last updated: 2024-10-16.

Condition(s): Early rectal cancer
Product: SGM-101

Primary endpoint: The ex-vivo NIR-fluorescence TDR (T1RC/HGD to LGD ratio) on bread loafs (macroscopic) and pathology slides (microscopic).
Endpoint(s): Ex-vivo NIR-fluorescence tumour-to-background ratio (TBR) and dysplasia-to-background ratio (DBR) (ex-vivo TDR already encountered within main objective) on whole specimen (Quest open camera, PEARL), bread loafs (Quest open camera and PEARL) and slides (dedicated 700nm microscopy scanner), In-vivo TDR, TBR and DBR, as measured with the Quest spectrum laparoscope., The accuracy of SGM-101 to discriminate T1RC/HGD from LGD ex-vivo on whole specimen (Quest open camera, PEARL), bread loafs (Quest open camera and PEARL) and slides (dedicated 700nm microscopy scanner). A TDR of ≥1,5 is defined as true positive. A TDR of <1.5 is defined as false negative. The accuracy is defined as the percentage of patients that are true positive. Same analysis will be performed for TBR and DBR, The accuracy of SGM-101 to discriminate T1RC/HGD from LGD in-vivo with the Quest laparoscope. Accompanying endpoint is the percentage of true positives (fluorescent spot in- vivo correlated to T1RC/HGD at pathology), false negatives (no fluorescent hotspot in vivo, T1RC/HGD component at pathology), false positives (fluorescent hotspot in-vivo, no T1RC/HGD at pathology) and true negatives (no fluorescent hotspot in vivo, no T1RC/HGD at pathology), The correlation between in-vivo TBR/TDR and Kudo level (SM1 vs SM2/3), The agreement of resection margins status (R0 vs R1) assessed by fluorescence and histopathology. A resection margin is classified positive when there is a fluorescent hotspot visible in the wound bed or on the specimen, The ratio of tissue CEA expression of T1RC/HGD divided by LGD, to TDR. The amount of CEA expression is determined by immunohistochemistry and quantified using the immunoreactive score (IRS)[28]. The ratio is calculated by dividing the IRS of T1RC/HGD by the IRS of LGD, after which this ratio is correlated to the TDR

Source: https://euclinicaltrials.eu/ctis-public/view/2024-510769-41-00